EU clinical trial 2022-501095-25-01: An Open-label Study to Evaluate the Safety, Efficacy, Pharmacokinetics, Pharmacodynamics, and Immunogenicity of Cipaglucosidase Alfa/Miglustat in Both ERT-experienced and ERT-naïve Pediatric Subjects with Infantile-onset Pompe Disease Aged 0 to <18 Years
Protocol code: ATB200-08
Sponsor: Amicus Therapeutics Inc. (Pharmaceutical company). Phase: Therapeutic confirmatory (Phase III). Countries: Italy (ongoing, recruiting), Germany (ongoing, recruiting), France (ended), Netherlands (ongoing, recruiting), Denmark (ongoing, recruiting).
Therapeutic area(s): Diseases [C] - Congenital, Hereditary, and Neonatal Diseases and Abnormalities [C16]
Gender: Female, Male. Age: 0-17 years. Enrolment: 16.
Start date (EU): 2024-11-04. Decision date: 2023-10-19. Results received: No. Last updated: 2026-03-30.
Decision dates by country: FR: 2023-10-20, IT: 2023-10-19, DE: 2023-10-19, NL: 2025-02-24, DK: 2026-03-30

Condition(s): Pediatric Subjects with Infantile-onset Pompe Disease Aged 0 to < 18 Years
Product: Miglustat Oral Solution 40 mg/mL, AT2221, ATB200

Primary endpoint: The primary endpoint is the proportion of subjects with infusion-associated reactions (IARs).
Endpoint(s): incidence of treatment-emergent adverse events (TEAEs), including treatment-emergent serious adverse events (TESAEs), hypersensitivity/anaphylactic reactions, and TEAEs leading to discontinuation of study drug, changes in clinical laboratory test results, changes in vital signs, changes in 12-lead ECG results, changes in echocardiogram parameters (other than LVMI)

Source: https://euclinicaltrials.eu/ctis-public/view/2022-501095-25-01